EU clinical trial 2022-502455-57-01: Glucagon enhanced insulin absorption in Diabetes Mellitus type 1
Sponsor: St. Olavs Hospital HF (Hospital/Clinic/Other health care facility). Phase: Therapeutic exploratory (Phase II). Countries: Norway (ended).
Therapeutic area(s): Diseases [C] - Hormonal diseases [C19]
Gender: Female, Male. Age: 18-64 years, 65+ years. Enrolment: 30.
Status: Ended. Start date (EU): 2023-06-20. End date (EU): 2023-12-22. Decision date: 2023-03-29. Results received: Yes. Last updated: 2023-03-29.

Condition(s): Diabetes mellitus type 1
Product: GLUCAGON

Primary endpoint: Area under the glucose curve for the first 60 minutes.
Endpoint(s): Area under glucose curve for any other time span during the first 3 hours., Area under the insulin curve for any time span during the first 3 hours, Area under the glucagon curve for any time span during thefirst 3 hours., Pharmacokinetic estimates for insulin., Pharmacokinetic estimates for glucagon., Thermal camera measurements., Laser doppler flowmetry measurements.

Source: https://euclinicaltrials.eu/ctis-public/view/2022-502455-57-01